EU clinical trial 2024-514907-32-00: Sarcomas and DDR-Inhibition; a neoadjuvant phase I combined modality study - SADDRIN-1
Protocol code: M21SAD
Sponsor: Het Nederlands Kanker Instituut-Antoni van Leeuwenhoek Ziekenhuis Stichting (Hospital/Clinic/Other health care facility). Phase: Human Pharmacology (Phase I)- Other. Countries: Netherlands (ended).
Therapeutic area(s): Diseases [C] - Skin and Connective Tissue Diseases [C17]; Diseases [C] - Neoplasms [C04]
Gender: Female, Male. Age: 18-64 years, 65+ years. Enrolment: 30.
Status: Ended. Start date (EU): 2022-01-21. End date (EU): 2025-12-09. Decision date: 2024-10-24. Results received: No. Last updated: 2024-10-24.

Condition(s): non-metastatic soft tissue sarcoma

Source: https://euclinicaltrials.eu/ctis-public/view/2024-514907-32-00